EU clinical trial 2024-512528-13-00: Study to Evaluate the Safety, Tolerability, and Pharmacokinetics of ION464 Administered to Adults With Multiple System Atrophy (HORIZON)
Protocol code: 262SP101(ION464-CS1)
Sponsor: Ionis Pharmaceuticals Inc. (Pharmaceutical company). Phase: Human Pharmacology (Phase I)- First administration to humans. Countries: France (ongoing, recruiting), Portugal (ongoing, recruiting), Austria (ongoing, recruiting), Germany (ongoing, recruiting).
Therapeutic area(s): Diseases [C] - Nervous System Diseases [C10]
Gender: Female, Male. Age: 18-64 years, 65+ years. Enrolment: 65.
Status: Ongoing, recruiting. Start date (EU): 2020-05-27. Decision date: 2024-08-14. Results received: No. Last updated: 2026-01-28.
Decision dates by country: DE: 2024-08-14, PT: 2024-08-16, AT: 2024-08-20, FR: 2024-08-20

Condition(s): Multiple System Atrophy

Source: https://euclinicaltrials.eu/ctis-public/view/2024-512528-13-00